EU clinical trial 2023-508896-35-00: Live birth after additional tubal flushing with oil-based contrast versus no additional flushing: a randomised, multicentre, parallel group pragmatic trial in infertile women with at least one patent tube at Hysterosalpingo-foam sonography
Protocol code: HYFOIL
Sponsor: Antwerp University Hospital (Hospital/Clinic/Other health care facility). Phase: Therapeutic use (Phase IV). Countries: Belgium (ongoing, recruitment ended).
Therapeutic area(s): Phenomena and Processes [G] - Reproductive and Urinary Physiological Phenomena [G08]
Gender: Female. Age: 18-64 years. Enrolment: 736.
Status: Ongoing, recruitment ended. Start date (EU): 2024-07-12. Decision date: 2024-07-12. Results received: No. Last updated: 2024-12-13.

Condition(s): Infertile women with at least one patent tube at Hysterosalpingo-foam sonography
Product: Lipiodol Ultra-Fluide, 480 mg I/ml, solution injectable

Primary endpoint: the occurrence of live birth, counting from the first day of the last menstrual cycle in which the patient conceives within 6 months after Hyfosy.

Source: https://euclinicaltrials.eu/ctis-public/view/2023-508896-35-00